EU clinical trial 2025-522976-10-00: The pivotal bioequivalence study comparing the test product to the reference product, which belongs to the group of medicines used in treatment of type 2 diabetes mellitus in adults and children aged 10 years and above, and heart failure and chronic kidney disease in adults patiens.
Protocol code: 1046/25
Sponsor: Adamed Pharma S.A. (Pharmaceutical company). Phase: Human Pharmacology (Phase I)- Bioequivalence Study. Countries: Czechia (ended).
Therapeutic area(s): Diseases [C] - Cardiovascular Diseases [C14]; Diseases [C] - Nutritional and Metabolic Diseases [C18]
Gender: Female, Male. Age: 18-64 years. Enrolment: 44.
Status: Ended. Start date (EU): 2025-09-10. End date (EU): 2025-11-24. Decision date: 2025-08-19. Results received: No. Last updated: 2025-11-19.
Decision dates by country: CZ: 2025-09-03

Condition(s): Not applicable (submitted trial is a BE study in healthy subjects.

Source: https://euclinicaltrials.eu/ctis-public/view/2025-522976-10-00